EU clinical trial 2024-511253-21-00: AMG 193 Alone or in Combination With Other Therapies in Subjects With Advanced Thoracic Tumors With Homozygous MTAP-deletion (Master Protocol)
Protocol code: 20230167
Sponsor: Amgen Inc. (Pharmaceutical company). Phase: Human Pharmacology (Phase I)- Other. Countries: Italy (ended), Belgium (ended), Germany (ongoing, recruitment ended), Spain (ended), Greece (ongoing, recruitment ended), Netherlands (ended), Poland (ongoing, recruitment ended), Austria (ongoing, recruitment ended), France (ongoing, recruitment ended).
Therapeutic area(s): Diseases [C] - Neoplasms [C04]
Gender: Female, Male. Age: 18-64 years, 65+ years. Enrolment: 42.
Start date (EU): 2025-02-28. Decision date: 2024-07-29. Results received: No. Last updated: 2026-07-13.
Decision dates by country: NL: 2024-07-30, AT: 2024-08-05, PL: 2024-08-04, DE: 2024-07-31, ES: 2024-08-01, FR: 2024-08-01, BE: 2024-07-29, GR: 2024-08-01, IT: 2024-08-01

Condition(s): Thoracic tumors with homozygous MTAP-deletion

Source: https://euclinicaltrials.eu/ctis-public/view/2024-511253-21-00